EU clinical trial 2023-508869-32-00: A randomized, Phase 3, open label study evaluating subcutaneous versus intravenous administration of isatuximab in combination with pomalidomide and dexamethasone in adult patients with relapsed and/or refractory multiple myeloma (RRMM)
Protocol code: EFC15951
Sponsor: Sanofi-Aventis Recherche & Developpement (Pharmaceutical company). Phase: Therapeutic confirmatory (Phase III). Countries: France (ongoing, recruitment ended), Italy (ongoing, recruitment ended), Germany (ongoing, recruitment ended), Poland (ongoing, recruitment ended), Czechia (ongoing, recruitment ended), Hungary (ongoing, recruitment ended), Norway (ongoing, recruitment ended), Sweden (ongoing, recruitment ended), Spain (ongoing, recruitment ended), Greece (ongoing, recruitment ended).
Therapeutic area(s): Diseases [C] - Neoplasms [C04]
Gender: Female, Male. Age: 65+ years. Enrolment: 217.
Status: Ongoing, recruitment ended. Start date (EU): 2022-11-10. Decision date: 2024-05-14. Results received: No. Last updated: 2026-05-15.
Decision dates by country: CZ: 2024-05-20, GR: 2024-07-30, ES: 2024-05-14, PL: 2024-05-24, HU: 2024-05-16, DE: 2024-05-15, FR: 2024-05-30, IT: 2024-06-03, NO: 2024-05-14, SE: 2024-06-11

Condition(s): Cancer - Plasma cell myeloma recurrent
Product: Imnovid 3 mg hard capsules, Isatuximab, Dexamethason 4 mg JENAPHARM®, JAMP Pomalidomide, JAMP Pomalidomide, Isatuximab, Imnovid 4 mg hard capsules, JAMP Pomalidomide, MONTELUKAST, Pomalidomide Adalvo 4 mg hard capsules, JAMP Pomalidomide, Imnovid 2 mg hard capsules, Pomalidomide Adalvo 2 mg hard capsules, Imnovid 1 mg hard capsules, Pomalidomide Adalvo 3 mg hard capsules, DEXAMETHASONE, Imnovid 1 mg hard capsules, Isatuximab, Imnovid 2 mg hard capsules, Pomalidomide Adalvo 1 mg hard capsules, Dexamethason 8 mg JENAPHARM®, Imnovid 3 mg hard capsules, Imnovid 4 mg hard capsules

Primary endpoint: Overall response rate (ORR), Observed concentration before dosing (Cthrough) at steady state
Endpoint(s): Very Good Partial Response or better rate (VGPR, Observed concentration before dosing (Ctrough), Incidence rate of infusion-reactions, Percentage of participants satisfied or very satisfied with the injection method used to administer study medication, Duration of response (DOR), Time to first response (TT1R), Time to best response (TTBR), Progression free survival (PFS), Overall survival (OS), Progression free survival 2 (PFS2), Number of participants with treatment-emergent adverse events (TEAEs)/serious adverse events (SAEs), Pharmacokinetic (PK) parameter: Maximum plasma concentration (Cmax), PK parameter: Area under the plasma concentration time curve over the dosing period (AUC), Successful injection rate, Percentage of participants with anti-drug antibodies (ADA) against isatuximab, Participant expectation questionnaire-baseline (PEQ-BL) score, Patient experience and satisfaction questionnaire- follow up (PESQ-FU) score, Patient experience and satisfaction questionnaire-end of treatment (PESQ-EOT) score, Patient’s Assessment of Treatment (PAT) questionnaire score, Change from baseline in the Health Resource Utilization and Productivity Questionnaire (HRUPQ) scores, Change from baseline in European Organization for Research and Treatment of Cancer core quality of life questionnaire (EORTC QLQ-C30) score, Change from baseline in European Organization for Research and Treatment of Cancer quality of life myeloma module (EORTC QLQ-MY20), Change from baseline in the European Quality of Life Group questionnaire with 5 dimensions and 5 levels per dimension (EQ-5D-5L) scores, Number of participants with chromosomal abnormalities

Source: https://euclinicaltrials.eu/ctis-public/view/2023-508869-32-00